EU clinical trial 2023-505362-28-00: A Phase 3, Multicenter, Randomized, Double-Blind Study of MK-7684 with Pembrolizumab as a Coformulation (MK-7684A) Versus Pembrolizumab Monotherapy as First Line Treatment for Participants With PD-L1 Positive Metastatic Non-Small Cell Lung Cancer (KEYVIBE-003)
Protocol code: MK-7684A-003
Sponsor: Merck Sharp & Dohme LLC (Pharmaceutical company). Phase: Therapeutic confirmatory (Phase III). Countries: Romania (ended), Hungary (ended).
Therapeutic area(s): Diseases [C] - Neoplasms [C04]
Gender: Female, Male. Age: 18-64 years, 65+ years. Enrolment: 156.
Status: Ended. Start date (EU): 2021-04-21. End date (EU): 2026-01-20. End date: 2026-01-27. Decision date: 2023-10-23. Results received: No. Last updated: 2025-09-02.
Decision dates by country: RO: 2023-10-23, HU: 2023-10-25

Condition(s): Stage IV non small-cell lung cancer
Product: KEYTRUDA 25 mg/mL concentrate for solution for infusion, MK-7684A

Primary endpoint: Overall Survival (OS) in Participants With Programmed Cell Death Ligand 1 (PD-L1) Tumor Proportion Score (TPS) ≥50%
Endpoint(s): OS in Participants With PD-L1 TPS ≥1%, OS in Participants With PD-L1 TPS 1% to 49%, Progression-Free Survival (PFS) in Participants With PD-L1 TPS ≥1%, PFS in Participants With PD-L1 TPS ≥50%, Objective Response Rate (ORR) in Participants With PD-L1 TPS ≥1%, PFS in Participants With PD-L1 TPS 1% to 49%, ORR in Participants With PD-L1 TPS ≥50%, ORR in Participants With PD-L1 TPS 1% to 49%, Duration of Response (DOR) in Participants With PD-L1 TPS ≥50%, DOR in Participants With PD-L1 TPS 1% to 49%, DOR in Participants With PD-L1 TPS ≥1%, Change from Baseline in Global Health Status/Quality of Life (QoL) (Items 29, 30) Combined Score on the European Organization for Research and Treatment of Cancer QoL Questionnaire-Core 30 (EORTC QLQ-C30) by PD-L1 TPS Subgroup (≥1%, 1%-49%, ≥50%), Change from Baseline in Physical Functioning (Items 1-5) Combined Score on the EORTC QLQ-C30 by PD-L1 TPS Subgroup (≥1%, 1%-49%, ≥50%), Change from Baseline in Role Functioning (Items 6, 7) Combined Score on the EORTC QLQ-C30 by PD-L1 TPS Subgroup (≥1%, 1%-49%, ≥50%), Change from Baseline in Dyspnea Score (Item 8) on the EORTC QLQ-C30 by PD-L1 TPS Subgroup (≥1%, 1%-49%, ≥50%), Change from Baseline in Cough Score (Item 31) on the European Organization for Research and Treatment of Cancer Quality of Life Lung Cancer-Specific Questionnaire Module (EORTC QLQ-LC13) by PD-L1 TPS Subgroup (≥1%, 1%-49%, ≥50%), Change from Baseline in Chest Pain Score (Item 40) on the EORTC QLQ-LC13 by PD-L1 TPS Subgroup (≥1%, 1%-49%, ≥50%), Time to Deterioration (TTD) in Global Health Status/QoL (Items 29, 30) Combined Score on the EORTC QLQ-C30 by PD-L1 TPS Subgroup (≥1%, 1%-49%, ≥50%), TTD in Physical Functioning (Items 1-5) Combined Score on the EORTC QLQ-C30 by PD-L1 TPS Subgroup (≥1%, 1%-49%, ≥50%), TTD in Role Functioning (Items 6, 7) Combined Score on the EORTC QLQ-C30 by PD-L1 TPS Subgroup (≥1%, 1%-49%, ≥50%), TTD in Dyspnea Score (Item 8) on the EORTC QLQ-C30 by PD-L1 TPS Subgroup (≥1%, 1%-49%, ≥50%), TTD in Cough Score (Item 31) on the EORTC QLQ-LC13 by PD-L1 TPS Subgroup (≥1%, 1%-49%, ≥50%), TTD in in Chest Pain Score (Item 40) on the EORTC QLQ-LC13 by PD-L1 TPS Subgroup (≥1%, 1%-49%, ≥50%), Number of Participants Who Experienced One or More Adverse Events (AEs), Number of Participants Who Discontinued Study Intervention Due to an Adverse Event (AE)

Source: https://euclinicaltrials.eu/ctis-public/view/2023-505362-28-00